EU clinical trial 2024-515475-35-00: Glucocorticoid enhancement of food exposure therapy in Binge Eating Disorder
Protocol code: 2020-01131
Sponsor: Universitaetsmedizin Goettingen (Hospital/Clinic/Other health care facility). Phase: Therapeutic exploratory (Phase II). Countries: Germany (ended).
Therapeutic area(s): Psychiatry and Psychology [F] - Mental Disorders [F03]
Gender: Female, Male. Age: 18-64 years. Enrolment: 50.
Status: Ended. Start date (EU): 2023-03-20. End date (EU): 2026-03-04. Decision date: 2024-07-23. Results received: No. Last updated: 2024-07-23.

Condition(s): Binge Eating Disorder
Product: Füllstoff DAC in hard gelatine capsules is used as placebo. Füllstoff DAC consists of mannitol 99.5 % and colloidal Silicon Dioxide 0.5 %., Hydrocortison 10 mg JENAPHARM® Tabletten

Primary endpoint: decrease of food craving in response to real food 3-7 days after treatment
Endpoint(s): decrease in fear of loss of control over eating and arousal/distress in response to real food, food craving in response to visual food cues, amount of food intake, trait level food craving 3-7 days after treatment and 1 month after treatment, decrease in number of days and episodes of binge eating and overeating 1 month after treatment, continuous decrease in food craving, fear of loss of control over eating and arousal/distress during intervention sessions

Source: https://euclinicaltrials.eu/ctis-public/view/2024-515475-35-00